EU clinical trial 2023-506032-33-00: PSMA PET For intermediate- or high-risk prostate cancer prior to RadioTherapY: A prospective interventional randomized clinical trial (P4RTY)
Protocol code: P4RTY
Sponsor: Universitaetsklinikum Essen AöR (Hospital/Clinic/Other health care facility). Phase: Therapeutic confirmatory (Phase III). Countries: Germany (authorised, recruitment pending).
Therapeutic area(s): Analytical, Diagnostic and Therapeutic Techniques and Equipment [E] - Investigative Techniques [E05]; Analytical, Diagnostic and Therapeutic Techniques and Equipment [E] - Therapeutics [E02]
Gender: Male. Age: 18-64 years, 65+ years. Enrolment: 352.
Status: Authorised, recruitment pending. Decision date: 2025-07-04. Results received: No. Last updated: 2025-07-04.

Condition(s): Prostate cancer
Product: Locametz 25 micrograms kit for radiopharmaceutical preparation

Primary endpoint: Progression-free survival (PFS), defined as time from initiation of RT to - biochemical recurrence defined as a rise by 2 ng/mL or more above the nadir PSA (defined as the lowest PSA achieved) after radiotherapy with or without short-term hormonal therapy [71] - appearance of metastases or loco-regional recurrence as defined below - death from any cause whichever occurs first
Endpoint(s): Change in initial treatment intent, Metastasis-free survival (MFS), defined as time from initiation of RT to occurrence of new metastases defined as - PET or radiographic bone or soft tissue distant metastases by blinded independent central review* - pathologic finding of distant metastases - death from any cause whichever occurs first, Loco-regional control (pelvis) Occurrence of loco-regional progression defined as (whichever occurs first): - PET or radiographic pelvic non-bone PCa lesions by blinded independent central review* - Pathologic finding of pelvic non-bone PCa lesions, Overall survival (OS), defined as time from initiation of RT to death from any cause., Post-salvage bPFS - In patients without salvage therapy: Time from initiation of RT until progression as defined above (primary endpoint) - In patients with salvage therapy: Time from initiation of RT until progression post-salvage therapy as defined above (primary endpoint) *Following the joint EAU ESUR ESTRO SIOG 2018 guideline, Section 6.3.4.4, Safety endpoints: Adverse events of CTC grade ≥3 and serious adverse events (SAE) according to the NCI Common Terminology Criteria for Adverse Events (CTCAE, v5.0, 2017).

Source: https://euclinicaltrials.eu/ctis-public/view/2023-506032-33-00